EU clinical trial 2022-500586-27-00: Antibiotics, Microbiology and Immunology in Children with Chronic wet Cough - the AMIC study
Protocol code: AMIC 002
Sponsor: Stavanger University Hospital (Hospital/Clinic/Other health care facility). Phase: Therapeutic use (Phase IV). Countries: Norway (ongoing, recruiting).
Therapeutic area(s): Diseases [C] - Respiratory Tract Diseases [C08]; Diseases [C] - Bacterial Infections and Mycoses [C01]
Gender: Female, Male. Age: 0-17 years. Enrolment: 350.
Status: Ongoing, recruiting. Start date (EU): 2023-08-15. Decision date: 2023-04-19. Results received: No. Last updated: 2023-12-13.

Condition(s): Chronic wet cough in young children
Product: Placebo granulate, Augmentin 400 mg/57 mg/5 ml pulver til mikstur, suspensjon (blandet fruktsmak)

Primary endpoint: Response to treatment of amoxicillin-clavulanate is defined as baseline cough score ≤2 in validated Verbal category descriptive (VCD) cough score at the end of treatment or cessation of coughing (VCD =0) for a minimum period of 3 days within the treatment period. VCD score (0-10 points) will be reported by parents. Baseline cough score is the mean cough score of the three days before start of treatment (days -3 to -1)., Time to relapse is defined as the time from end of treatment (FU1) to start of relapse. Relapse of symptoms is defined as a new period of wet cough - after a period of at least seven days without symptoms - lasting for more than four weeks or an episode of wet cough of at least two weeks duration which was treated with antibiotics by the child’s general practitioner or treating physician. The start of relapse is the first day with cough of such a period or episode.
Endpoint(s): Respiratory pathogens (virus and bacteria) detected by conventional methods (PCR and culture) in children with CWC and healthy controls., Airway and gut microbiome diversity/composition in children with CWC and healthy controls, Inflammatory markers and patterns of these markers in laryngeal aspirate and peripheral blood from children with CWC compared and healthy controls., Functional markers (not genetics) of Primay immunodeficiencies (PID) (Immunoglobulins, lymphocyte populations, complement function, vaccine response) in children with CWC and healthy controls., Proportion of children diagnosed with primary immunodeficiencies (PID) based on Next-generation sequencing (NGS) panel for PID in children with CWC., Day by day response to treatment (≤2 in VCD score)in those receiving 14 days treatment with amoxicillin-clavulanate and those receiving placebo., Quality of life score in children with CWC and controls., Day by day response to treatment (≤2 in VCD score).

Source: https://euclinicaltrials.eu/ctis-public/view/2022-500586-27-00